EU clinical trial 2022-503113-31-01: A multi-center, randomized, double blind, placebo-controlled, phase 2 pilot efficacy study to investigate the efficacy of oral lidocaine (ORE-001) in preventing gastrointestinal disturbance/intolerance in patients after longitudinal laparotomy
Protocol code: ORE001PhIIPOI
Sponsor: Orexa B.V. (Pharmaceutical company). Phase: Therapeutic exploratory (Phase II). Countries: Germany (ended).
Therapeutic area(s): Diseases [C] - Digestive System Diseases [C06]
Gender: Female. Age: 18-64 years, 65+ years. Enrolment: 126.
Status: Ended. Start date (EU): 2023-12-19. End date (EU): 2025-06-24. Decision date: 2023-09-12. Results received: Yes. Last updated: 2025-02-12.

Condition(s): longitudinal laparotomy
Product: The placebo tablets are white to off-white, round, film-coated tablets with a diameter of approximately 10 mm. The placebo tablets are packaged in PVC/Alu blisters (4’s).

Primary endpoint: I-FEED score at POD3
Endpoint(s): I-FEED score at POD1, POD2 and from POD4 at each scheduled time point up to POD8 (with possible extension to POD12), Mean duration patients reach an I-FEED score of 0-2 (in days), Mean duration patients reach increased I-FEED score > 2 (in days), Change of I-FEED scores at each scheduled timepoint, Treatment Emergent Adverse Events (TEAEs) up to EOS (continuous), Treatment Emergent Serious Adverse Events (TESAEs) up to EOS (continuous), Change from Baseline to each scheduled time point up to EOS for Vital signs, Change from Baseline to each scheduled time point up to Day after last study drug administration for ECG, Change from Baseline to each scheduled time point up to Day of last study drug administration for routine laboratory tests and urine analysis, Change from Baseline to Day after last study drug administration for Physical examination, Treatment-emergent AEs leading to premature discontinuation of study drug.

Source: https://euclinicaltrials.eu/ctis-public/view/2022-503113-31-01